EU clinical trial 2024-517946-32-00: A 12-month follow up study of probiotic supplementation effects in subjects with autoimmune uveitis.
Protocol code: VFN-MIU-2021-01
Sponsor: Vseobecna Fakultni Nemocnice V Praze (Hospital/Clinic/Other health care facility). Phase: Therapeutic exploratory (Phase II). Countries: Czechia (ongoing, recruiting).
Therapeutic area(s): Diseases [C] - Immune System Diseases [C20]; Diseases [C] - Eye Diseases [C11]
Gender: Female, Male. Age: 18-64 years. Enrolment: 9.
Status: Ongoing, recruiting. Start date (EU): 2023-06-02. Decision date: 2024-12-09. Results received: No. Last updated: 2024-12-09.

Condition(s): Non-infectious uveitis
Product: Mutaflor

Primary endpoint: Time to first disease relapse from the baseline visit (V2)
Endpoint(s): Severity of first relapse according to the SUN system, Total number of relapses during the study, Changes in BCVA, Changes in OCT parameters

Source: https://euclinicaltrials.eu/ctis-public/view/2024-517946-32-00